EU clinical trial 2023-506974-11-00: Treatment of frontal fibrosing alopecia with microneedling and photodynamic therapy using 5-aminolevulinic acid in male and female adult participants – an open single group phase 2 study
Sponsor: Oslo University Hospital HF (Hospital/Clinic/Other health care facility). Phase: Therapeutic exploratory (Phase II). Countries: Norway (authorised, recruitment pending).
Therapeutic area(s): Diseases [C] - Skin and Connective Tissue Diseases [C17]
Gender: Female, Male. Age: 18-64 years, 65+ years. Enrolment: 15.
Status: Authorised, recruitment pending. Decision date: 2024-01-30. Results received: No. Last updated: 2024-01-30.

Condition(s): Frontal fibrosing alopecia (FFA)
Product: Metvix 160 mg/g Creme

Primary endpoint: Reduction of the combined scoring of erythema and hyperkeratosis at week 32 compared to baseline (week 0)
Endpoint(s): Reduction of the combined scoring of erythema and hyperkeratosis at week 4, 8, 20 and 32 compared to baseline (week 0), Reduction of the (FFA) Global Staging Score week 32 compared to baseline (week 0), Change in investigators global assessment score week 32 compared to baseline (week 0), Change in patient global assessment score week 32 compared to baseline (week 0), Percentage reduction of hair density at week 32 (ALODEXFFA score) compared to baseline (week 0), Percentage change of hair density at week 4, 8, 20 and 32 (ALODEXFFA score) compared to baseline (week 0), Percentage increased hair density at week 32 compared to baseline (negative ALODEXFFA score)

Source: https://euclinicaltrials.eu/ctis-public/view/2023-506974-11-00